EU clinical trial 2025-520563-41-00: An interventional, multicenter, and international phase 1/2, light-dose-escalation study to investigate the safety and feasibility of intraoperative photodynamic therapy (PDT) with Pentalafen® drug and Heliance® Solution device in male and female patients 18 to 75 years of age with grade IV glioblastoma.
Protocol code: HTX-GBM-01
Sponsor: Hemerion Therapeutics (Pharmaceutical company). Phase: Phase I and Phase II (Integrated)- First administration to humans. Countries: France (ongoing, recruitment ended).
Therapeutic area(s): Diseases [C] - Neoplasms [C04]
Gender: Female, Male. Age: 18-64 years, 65+ years. Enrolment: 6.
Status: Ongoing, recruitment ended. Start date (EU): 2025-09-29. Decision date: 2025-06-16. Results received: No. Last updated: 2025-06-16.

Condition(s): High-grade glioma Glioblastoma
Product: Pentalafen

Primary endpoint: MTD, which will be assessed on the basis of number of patients with DLT.
Endpoint(s): PFS6, defined as the interval (in days or months) from intraoperative PDT to the date of first detection of progressive disease., Number of AEs and SAEs, Score of device usability calculated from usefulness, ease of use, ease of learning and satisfaction/intention of use measures.

Source: https://euclinicaltrials.eu/ctis-public/view/2025-520563-41-00